EU clinical trial 2023-509613-37-01: A Phase 2a, dose-finding, randomized, double-blinded, placebo-controlled study to Evaluate the Pharmacodynamics, Pharmacokinetics, and Safety of Efavirenz in Patients with Early Alzheimer’s Disease
Sponsor: Amsterdam UMC (Hospital/Clinic/Other health care facility). Phase: Phase I and Phase II (Integrated)- Other. Countries: Netherlands (ongoing, recruiting).
Therapeutic area(s): Diseases [C] - Nervous System Diseases [C10]
Gender: Female, Male. Age: 18-64 years, 65+ years. Enrolment: 40.
Status: Ongoing, recruiting. Start date (EU): 2024-10-08. Decision date: 2024-06-10. Results received: No. Last updated: 2026-02-06.

Condition(s): Alzheimer's Disease
Product: Placebo Efavirenz tablets, EFAVIRENZ

Primary endpoint: Change From Baseline Levels in 24-Hydroxycholesterol in CSF
Endpoint(s): Changes from levels in 24-hydroxycholesterol at 3h, 6h, 24h, 7d, 28d, 56d, and 84d, Change From Baseline Levels in AD Biomarkers in CSF: pTau, tTau, Ab42, Ab40, Ab42/40, NFL, NRGN, GFAP, YKL-40, inflammatory cytokines, Change From Baseline Levels in AD Biomarkers in Plasma: pTau, tTau, Ab40, Ab42, Ab42/40m NFL, Exploratory cognition endpoints: MSSE, PK in plasma and CSF

Source: https://euclinicaltrials.eu/ctis-public/view/2023-509613-37-01